EU clinical trial 2022-502512-36-00: Hyperpolarized 129-Xenon MRI in Fibrosing Interstitial Lung Disease
Protocol code: Xe-F-ILD-001
Sponsor: Aarhus University (Educational Institution). Phase: Therapeutic exploratory (Phase II). Countries: Denmark (ongoing, recruitment ended).
Therapeutic area(s): Diseases [C] - Respiratory Tract Diseases [C08]; Analytical, Diagnostic and Therapeutic Techniques and Equipment [E] - Investigative Techniques [E05]
Gender: Female, Male. Age: 18-64 years, 65+ years. Enrolment: 39.
Status: Ongoing, recruitment ended. Start date (EU): 2023-10-02. Decision date: 2023-03-06. Results received: No. Last updated: 2025-01-31.

Condition(s): Progressive Fibrosing Interstitial Lung Diseases
Product: Gadovist, injektionsvæske, opløsning, Hyperpolarised 129Xe 400 ml, Hyperpolarised 129Xe 800 ml, Hyperpolarised 129Xe 650 ml, Hyperpolarised 129Xe 500 ml, Hyperpolarised 129Xe gas 1000 ml

Primary endpoint: MR xenon ventilation and dissolved parameters, Worsening of pulmonary function test parameters, Worsening of HRCT parameters, Worsening in patient reported symptoms
Endpoint(s): Regionally decreased perfusion, Evidence of myocardial stran and fibrosis, Late contrast enhancement

Source: https://euclinicaltrials.eu/ctis-public/view/2022-502512-36-00